EU clinical trial 2023-508429-29-00: A Randomized, Double-Blind, Placebo-Controlled, Phase 2b Study Evaluating the Safety and Efficacy of Pirfenidone Solution for Inhalation (AP01) in Subjects with Progressive Pulmonary Fibrosis (PPF)
Protocol code: AP01-007
Sponsor: Avalyn Pharma Inc. (Pharmaceutical company). Phase: Therapeutic exploratory (Phase II). Countries: France (ongoing, recruitment ended), Germany (ongoing, recruitment ended), Italy (ongoing, recruitment ended), Spain (ongoing, recruitment ended), Poland (ongoing, recruitment ended), Netherlands (ongoing, recruitment ended), Belgium (ongoing, recruitment ended).
Therapeutic area(s): Diseases [C] - Respiratory Tract Diseases [C08]
Gender: Female, Male. Age: 18-64 years, 65+ years. Enrolment: 182.
Status: Ongoing, recruitment ended. Start date (EU): 2024-09-26. Decision date: 2024-08-20. Results received: No. Last updated: 2026-06-29.
Decision dates by country: NL: 2025-07-16, FR: 2024-08-20, BE: 2025-07-01, ES: 2024-08-27, IT: 2024-08-23, DE: 2024-08-21, PL: 2024-08-30

Condition(s): Progressive Pulmonary Fibrosis
Product: Pirfenidone Solution for Inhalation, Pirfenidone Solution for Inhalation, Placebo for AP01

Primary endpoint: The main trial endpoint is the change from baseline in FVC, the maximum amount of air that can be exhaled when blowing out as fast as possible (measured in milliliters) at Week 52
Endpoint(s): Change from Baseline in QoL measurements as assessed by Living with Pulmonary Fibrosis Symptoms and Impact Questionnaire (L-PF) total score at Week 52, Time to disease progression. Disease progression is defined as absolute FVC percent predicted decline of ≥10% through Week 52 or all-cause death, Change in lung fibrosis score based on high-resolution computed tomography (HRCT) from Baseline to 52 weeks

Source: https://euclinicaltrials.eu/ctis-public/view/2023-508429-29-00